EU clinical trial 2023-509935-23-00: A Phase 2, Two-Part, Multiple-Ascending-Dose Study of SRP-5051 for Dose Determination, then Dose Expansion, in Patients with Duchenne Muscular Dystrophy Amenable to Exon 51-Skipping Treatment
Protocol code: 5051-201
Sponsor: Sarepta Therapeutics Inc. (Pharmaceutical company). Phase: Therapeutic exploratory (Phase II). Countries: Netherlands (ended), Spain (ended), Belgium (ended), Germany (ended), Italy (ended).
Therapeutic area(s): Diseases [C] - Congenital, Hereditary, and Neonatal Diseases and Abnormalities [C16]; Diseases [C] - Musculoskeletal Diseases [C05]
Gender: Male. Age: 0-17 years, 18-64 years. Enrolment: 21.
Status: Ended. Start date (EU): 2020-08-21. End date (EU): 2024-11-06. End date: 2025-02-07. Decision date: 2024-05-06. Results received: Yes. Last updated: 2024-10-07.
Decision dates by country: DE: 2024-05-08, NL: 2024-05-06, BE: 2024-05-07, IT: 2024-05-13, ES: 2024-05-06

Condition(s): Duchenne Muscular Dystrophy
Product: VESLETEPLIRSEN(SRP-5051)

Primary endpoint: Part A: Incidence of Adverse Events (AEs), Baseline up to 75 weeks, Part B: Change From Baseline in Dystrophin Protein Level at Week 28
Endpoint(s): Part A: Pharmacokinetics (PK): Plasma Concentration of Vesleteplirsen, Pre-dose and at multiple time points (up to 32 hours) after end of infusion, Part A: PK: Urine Concentration of Vesleteplirsen, Pre-dose and at multiple time periods (up to 48 hours) after end of infusion, Part B: Change From Baseline in Exon-Skipping Levels at Week 28, Part B: Incidence of Adverse Events (AEs), Baseline up to Week 304, Part B: PK: Plasma Concentration of Vesleteplirsen, Part B predose and at multiple timepoints (up to 48 hours) after end of infusion, Part B: PK: Urine Concentration of Vesleteplirsen, Part B predose and at multiple timepoints (up to 48 hours) after end of infusion, Part B: Change from Baseline in Percent Dystrophin-Positive Fibers (PDPF) and Mean Intensity, as Measured by Immunofluorescence Assay at Week 28

Source: https://euclinicaltrials.eu/ctis-public/view/2023-509935-23-00